EU clinical trial 2024-518204-50-00: A Phase III, Randomized, Open-Label Clinical Study of Napabucasin in Combination with FOLFIRI and Best Supportive Care (BSC) Versus Napabucasin plus BSC in Adult Patients with Previously Treated Metastatic Colorectal Cancer (CRC)
Protocol code: STEMNESS-CRC
Sponsor: 1globe Health Institute LLC (Pharmaceutical company). Phase: Therapeutic confirmatory (Phase III). Countries: Spain (ongoing, recruitment ended), France (ongoing, recruitment ended).
Therapeutic area(s): Diseases [C] - Neoplasms [C04]
Gender: Female, Male. Age: 18-64 years, 65+ years. Enrolment: 123.
Status: Ongoing, recruitment ended. Start date (EU): 2022-04-25. Decision date: 2024-11-11. Results received: No. Last updated: 2025-12-10.
Decision dates by country: FR: 2024-11-14, ES: 2024-11-11

Condition(s): Histologically confirmed adenocarcinoma of the colon or rectum that is metastatic.
Product: BENDAFOLIN 10 mg/ml Injektionslösung, Irinotecan Bendalis 20 mg/ml Konzentrat zur Herstellung einer Infusionslösung, 5-FLUOROURACIL–EBEWE, 50 MG/ML, ROZTWÓR DO WSTRZYKIWAN I INFUZJI, Napabucasin

Primary endpoint: Overall Survival in the general study population, defined as the time from randomization to death from any cause.
Endpoint(s): Progression free survival (PFS) in the general study population, Objective response rate (ORR) in the general study population, Disease control rate (DCR) in the general study population, OS, PFS, ORR and DCR in the predefined biomarker positive population, Safety, Quality of Life

Source: https://euclinicaltrials.eu/ctis-public/view/2024-518204-50-00